EU clinical trial 2024-513517-12-00: An open label, balanced, randomized, two-treatment, two-period, two-sequence, single-dose, crossover, bioequivalence study comparing Lisdexamfetamine Dimesylate capsules 70 mg, manufactured by Sun Pharmaceutical Industries Limited, India with Elvanse (lisdexamfetamine dimesylate) 70 mg hard capsules, Marketing Authorization Holder: Takeda Pharmaceuticals International AG Ireland Branch, Block 2, Miesian Plaza, 50-58 Baggot Street Lower, Dublin 2, D02 HW68, Ireland, in healthy adult, human subjects under fasting condition.
Protocol code: LISDE-06-24
Sponsor: Sun Pharmaceutical Industries Limited (Pharmaceutical company). Phase: Human Pharmacology (Phase I)- Bioequivalence Study. Countries: Romania (ended).
Therapeutic area(s): Psychiatry and Psychology [F] - Mental Disorders [F03]
Gender: Female, Male. Age: 18-64 years. Enrolment: 54.
Status: Ended. Start date (EU): 2025-10-01. End date (EU): 2025-11-05. Decision date: 2025-04-28. Results received: No. Last updated: 2025-04-28.

Condition(s): ADHD

Source: https://euclinicaltrials.eu/ctis-public/view/2024-513517-12-00